EU clinical trial 2024-515271-35-00: Intralymfatisk immunterapi förstärkt av vitamin-D, en randomiserad placebokontrollerad studie och jämförelse med SLIT
Sponsor: Karolinska University Hospital, Karolinska Institutet (Hospital/Clinic/Other health care facility, Educational Institution). Phase: Phase II and Phase III (Integrated). Countries: Sweden (ongoing, recruitment ended).
Therapeutic area(s): Diseases [C] - Immune System Diseases [C20]
Gender: Female, Male. Age: 18-64 years. Enrolment: 360.
Status: Ongoing, recruitment ended. Start date (EU): 2023-02-01. Decision date: 2024-07-09. Results received: No. Last updated: 2024-07-09.

Condition(s): Allergisk Rinit
Product: Natriumklorid Braun 9 mg/ml spädningsvätska för parenteral användning, COLECALCIFEROL, GRAZAX 75 000 SQ-T frystorkad sublingual tablett, Alutard SQ Timotej, 10 000 SQ-E/ml, injektionsvätska, suspension

Primary endpoint: Det primära utfallsmåttet är CSMS (Combined Symptom Medication Score) under gräspollensäsong efter behandlingen. CSMS jämförs med baslinjens CSMS samt med CSMS i placebogruppen. Baslinjen definieras som pollensäsong före behandling.
Endpoint(s): CSMS under gräspollensäsongstopp, före och efter behandling, Rhinoconjunctivitis Quality of Life Questionnaire (RQLQ) före och efter behandling, NTS score före och efter behandling, VAS (visual analogue scale) före och efter behandling, Analyser av nässköljning med flödescytometri, PCR och ELISA m.m för kvantifiering av immunceller och Th1 / Th2-cytokiner före och efter behandling, Nivåer av IgE, IgG, IgA och Th1 / Th2 cytokiner i serum före och efter behandlingen.

Source: https://euclinicaltrials.eu/ctis-public/view/2024-515271-35-00